EU clinical trial 2023-508234-34-00: A phase 2b, multicenter, double-blind, placebo-controlled, study to evaluate the efficacy, safety, pharmacokinetics, and pharmacodynamics of obefazimod in subjects with moderately to severely active Crohn’s disease
Protocol code: ABX464-202
Sponsor: Abivax (Pharmaceutical company). Phase: Therapeutic exploratory (Phase II). Countries: Hungary (ongoing, recruiting), Spain (ongoing, recruiting), Belgium (ongoing, recruiting), Italy (ongoing, recruiting), Czechia (ongoing, recruiting), Slovakia (ongoing, recruiting), France (ongoing, recruiting), Netherlands (ongoing, recruiting), Poland (ongoing, recruiting), Romania (ongoing, recruiting), Germany (ongoing, recruiting).
Therapeutic area(s): Diseases [C] - Digestive System Diseases [C06]
Gender: Female, Male. Age: 18-64 years, 65+ years. Enrolment: 139.
Status: Ongoing, recruiting. Start date (EU): 2025-01-27. Decision date: 2025-01-08. Results received: No. Last updated: 2026-05-06.
Decision dates by country: ES: 2025-01-13, NL: 2025-01-13, RO: 2025-01-13, SK: 2025-01-09, HU: 2025-01-13, DE: 2025-04-17, IT: 2025-01-13, FR: 2025-01-08, PL: 2025-01-11, BE: 2025-01-13, CZ: 2025-01-10

Condition(s): Crohn's disease
Product: obefazimod, Placebo for the 12.5 mg, 50 mg and 25mg ABX464 hard capsules., ABX464, ABX464

Primary endpoint: For induction and maintenance phase: change from baseline in CDAI score at Week 12 and Week 52.
Endpoint(s): For Induction and Maintenance phase: (efficacy) Change from baseline in SES-CD at Week 12 and at Week 52 respectively., For Induction phase and Maintenance phase: (efficacy) Proportion of subjects with endoscopic response at Week 12 and at Week 52 respectively., For Induction phase and Maintenance phase: (efficacy) Proportion of subjects with no SES-CD ulcer subscore > 1 in at least one segment at Week 12 and at Week 52 respectively., For Induction phase and Maintenance phase: (efficacy) Proportion of subjects with CDAI clinical remission at Week 12 and at Week 52 respectively., For Maintenance phase: (efficacy) Proportion of subjects with sustained CDAI clinical remission at Week 52., For Induction phase and Maintenance phase: (efficacy) Proportion of subjects with PRO-2 clinical remission at Week 12 and at Week 52 respectively., For Induction phase and Maintenance phase: (efficacy) Proportion of subjects with CDAI clinical response at Week 12 and at Week 52 respectively., For Induction phase and Maintenance phase: (efficacy) Proportion of subjects with PRO-2 clinical response at Week 12 and at Week 52 respectively, For Induction phase and Maintenance phase: (efficacy) Proportion of subjects with CDAI clinical response and endoscopic response at Week 12 and at Week 52 respectively, For Induction phase and Maintenance phase: (efficacy) Proportion of subjects with endoscopic remission at Week 12 and at Week 52 respectively, For Induction phase, Maintenance and Extension phase: Safety Incidence of all treatment-emergent adverse events (TEAEs), causally related TEAEs, all serious adverse events (SAE) and causally related SAEs., For Induction, Maintenance and Extension phase: Safety, Incidence of AEs leading to discontinuation, For Induction, Maintenance and Extension phase: (safety) incidence of adverse events of special interest (AESIs), For Induction, Maintenance and Extension phase: (safety) Incidence and severity of laboratory abnormalities and change from baseline in laboratory values, For Induction and Maintenance phase: PK, Obefazimod and its metabolites plasma concentrations at baseline and at specified timepoints during Induction and Maintenance and PK parameters as determined by population PK analysis

Source: https://euclinicaltrials.eu/ctis-public/view/2023-508234-34-00